EU clinical trial 2025-522652-58-01: A trial to test the safety and tolerability of Lu AH70212 and Lu AH69593 in healthy adults.
Protocol code: 21117A
Sponsor: H. Lundbeck A/S (Pharmaceutical company). Phase: Human Pharmacology (Phase I)- First administration to humans. Countries: France (ongoing, recruiting).
Therapeutic area(s): Diseases [C] - Nervous System Diseases [C10]
Gender: Female, Male. Age: 18-64 years. Enrolment: 104.
Status: Ongoing, recruiting. Start date (EU): 2026-02-19. Decision date: 2026-02-09. Results received: No. Last updated: 2026-07-10.

Condition(s): Narcolepsy

Source: https://euclinicaltrials.eu/ctis-public/view/2025-522652-58-01